EU clinical trial 2022-502060-21-00: Nuwiq for Perioperative management Of patients With haemophilia A on Emicizumab Regular prophylaxis study (NuPOWER)
Protocol code: GENA-22
Sponsor: Octapharma AG (Pharmaceutical company). Phase: Therapeutic use (Phase IV). Countries: Germany (ongoing, recruiting), France (ongoing, recruiting), Spain (ongoing, recruiting), Italy (ended), Croatia (ongoing, recruiting), Finland (authorised, recruiting).
Therapeutic area(s): Diseases [C] - Congenital, Hereditary, and Neonatal Diseases and Abnormalities [C16]
Gender: Male. Age: 0-17 years, 18-64 years, 65+ years. Enrolment: 45.
Start date (EU): 2023-10-19. Decision date: 2023-08-15. Results received: No. Last updated: 2025-09-25.
Decision dates by country: HR: 2023-09-11, FR: 2023-09-01, FI: 2024-02-27, IT: 2023-09-06, DE: 2023-08-15, ES: 2023-09-01

Condition(s): Haemophilia A
Product: Nuwiq 2500 IU powder and solvent for solution for injection, Nuwiq 4000 IU powder and solvent for solution for injection, Nuwiq 1000 IU powder and solvent for solution for injection, Nuwiq 1500 IU powder and solvent for solution for injection, Nuwiq 3000 IU powder and solvent for solution for injection, Nuwiq 250 IU powder and solvent for solution for injection, Nuwiq 500 IU powder and solvent for solution for injection, Nuwiq 2000 IU powder and solvent for solution for injection

Primary endpoint: The primary endpoint is the overall haemostatic efficacy (“success” or “failure”) of Nuwiq in severe haemophilia A patients receiving emicizumab prophylaxis and undergoing major surgery.
Endpoint(s): Assessment of intraoperative haemostatic efficacy of Nuwiq using a 4-point ordinal scale., Assessment of postoperative haemostatic efficacy of Nuwiq using a 4-point ordinal scale., Perioperative FVIII plasma levels immediately before (≤30 minutes) and after (15-30 minutes) Nuwiq injections., Perioperative haemostatic efficacy assessed using the 4-point scale recommended by the WFH., Incidence of adverse events (AEs)., Incidence of thrombotic events., Incidence of FVIII inhibitor formation., Number of allogeneic blood products (red blood cells, platelets, and other blood products) transfused, Perioperative TG immediately before (≤30 minutes) and after (15-30 minutes) Nuwiq injections

Source: https://euclinicaltrials.eu/ctis-public/view/2022-502060-21-00